EU clinical trial 2024-515892-36-00: Phase 2, multicenter, randomized, open-label, controlled, 2-arm cross-over study to evaluate the clinical efficacy and safety of a renin inhibitor, aliskiren, compared to an angiotensin converting enzyme inhibitor, enalapril, in children and adults with C3 glomerulopathy
Sponsor: Region Skane (Hospital/Clinic/Other health care facility). Phase: Therapeutic exploratory (Phase II). Countries: Sweden (ended).
Therapeutic area(s): Diseases [C] - Immune System Diseases [C20]; Diseases [C] - Pathological Conditions, Signs and Symptoms [C23]
Gender: Female, Male. Age: 0-17 years, 18-64 years, 65+ years. Enrolment: 30.
Status: Ended. Start date (EU): 2020-01-01. End date (EU): 2025-10-24. Decision date: 2024-07-10. Results received: Yes. Last updated: 2024-07-10.

Condition(s): C3 glomerulopathy
Product: Enalapril Viatris 5 mg comprimidos EFG, Rasilez 300 mg film-coated tablets

Primary endpoint: Serum C3 during the cross-over study., Serum C3 and complement deposition in renal biopsies during the extension study.
Endpoint(s): Complement activation (such as serum C3a, C3d, C5a and other complement assays), Proteinuria, Kidney function, Kidney biopsy findings, Blood pressure, Activation of the renin-angiotensin system

Source: https://euclinicaltrials.eu/ctis-public/view/2024-515892-36-00